EU clinical trial 2024-513219-29-00: Renal Adjuvant MultiPle Arm Randomised Trial (RAMPART): An international investigator-led phase III multi-arm multi-stage multi-centre randomised controlled platform trial of adjuvant therapy in patients with resected primary renal cell carcinoma (RCC) at high or intermediate risk of relapse
Sponsor: University College London (Educational Institution). Phase: Therapeutic confirmatory (Phase III). Countries: France (authorised, recruiting), Spain (authorised, recruitment pending).
Therapeutic area(s): Diseases [C] - Neoplasms [C04]
Gender: Female, Male. Age: 18-64 years, 65+ years. Enrolment: 203.
Start date (EU): 2024-10-21. Decision date: 2024-10-16. Results received: No. Last updated: 2026-02-13.
Decision dates by country: FR: 2024-10-18, ES: 2024-10-16

Condition(s): Renal Cell Carcinoma
Product: IMFINZI 50 mg/mL concentrate for solution for infusion., IMJUDO 20 mg/ml concentrate for solution for infusion.

Primary endpoint: Disease Free Survival - defined as the interval from randomisation to first evidence of local recurrence, new primary RCC, distant metastases, or death from any cause, whichever occurs first., Overall Survival - defined as all-cause mortality, the time from randomisation to death from any cause (including RCC).
Endpoint(s): Metastasis Free Survival (MFS), defined as the interval from randomisation to first evidence of metastases or death from RCC., RCC specific survival time, defined as the time from randomisation to death from RCC., Quality of life, Toxicity, Patient preferences for adjuvant immunotherapy

Source: https://euclinicaltrials.eu/ctis-public/view/2024-513219-29-00